EU clinical trial 2023-503283-17-00: Treatment of anaemia after caesarean with intravenous versus oral iron and postpartum depression: a multicentric randomized open-labelled controlled trial (IRON-DEP)
Protocol code: APHP220806
Sponsor: Assistance Publique Hopitaux De Paris (Hospital/Clinic/Other health care facility). Phase: Therapeutic use (Phase IV). Countries: France (ongoing, recruiting).
Therapeutic area(s): Psychiatry and Psychology [F] - Mental Disorders [F03]
Gender: Female. Age: 18-64 years. Enrolment: 2860.
Status: Ongoing, recruiting. Start date (EU): 2025-10-22. Decision date: 2024-04-05. Results received: No. Last updated: 2026-03-16.

Condition(s): Women who delivered by caesarean and have a moderate postpartum iron deficiency anaemia defined by 8.0 g/dL ≤ postoperative Hb level ≤ 10.0 g/dL within 72h after delivery and a ferritinemia ≤ 100 ng/mL OR transferrin saturation ≤ 20% (Measured after postoperative Hb level measurement)
Product: TIMOFEROL 50 mg, comprimé enrobé, TIMOFEROL, gélule, FERRIC CARBOXYMALTOSE

Primary endpoint: The primary endpoint is the prevalence of PPD symptoms at 8 weeks postpartum, defined by an Edinburg Postpartum Depression Scale (EPDS) score ≥ 11, measured by a self-assessment questionnaire.
Endpoint(s): At 8 weeks postpartum • Average Hb level • Proportion of women with Hb < 12.0 g/dL • Mean serum ferritin • proportion of women with serum ferritin < 20ng/mL At inclusion and 8 weeks postpartum: Average change in Hb level between inclusion and 8 weeks postpartum, At 8 weeks postpartum • The average EPDS score • The proportion of patients presenting symptoms of moderate depression (EPDS ≥ 11 and <13) and • The proportion of patients presenting symptoms of marked depression (EPDS≥13). • The need for a transfusion of packed blood cells during the 8 weeks postpartum • The average fatigue score measured by the self-questionnaire Multidimensional Fatigue Inventory score-20 (MFI-20) overall and for each of the 5 dimensions evaluated: general fatigue, physical f, At 6 months postpartum • The occurrence of long-term PPD, assessed by the proportion of women with an EPDS score ≥ 11, the average EPDS score at 6 months, the average change in the EPDS score between 8 weeks and 6 months postpartum and the proportion of women with EPDS ≥ 13 • The average fatigue score (MFI-20 score) overall and in each of its 5 dimensions, the average variation in the MFI-20 score between 8 weeks and 6 months postpartum • The bond between mother and child (average MIBS score and, Upon administration of the product and at 8 weeks • Immune reactions (hypersensitivity reaction, bronchospasm, urticaria, flushing, itching) during IV iron administration and up to 30 minutes after stopping it • Skin pigmentation secondary to IV iron extravasation within 8 weeks of delivery At 8 weeks • Gastrointestinal side effects in the IV and oral iron groups (constipation, abdominal pain, dyspepsia, muscle cramps, nausea and vomiting) within 8 weeks postpartum, At 8 weeks: Good treatment compliance is defined by taking >80% of the prescribed treatment during the 8 weeks of treatment., At inclusion, 8 weeks and 6 months postpartum: Estimated total cost of healthcare use assessed by: EQ-5D-5L Postpartum hospitalizations use of outpatient care

Source: https://euclinicaltrials.eu/ctis-public/view/2023-503283-17-00